EU clinical trial 2025-523725-17-00: Inducing durable immunological control of HIV-1 through administration of long-acting broadly neutralizing antibodies and low-dose anti-PD-1 – a randomized, double-blinded, placebo-controlled trial (the IDUNN trial)
Protocol code: IDUNN-001
Sponsor: Region Midtjylland (Hospital/Clinic/Other health care facility). Phase: Therapeutic exploratory (Phase II). Countries: Sweden (authorised, recruitment pending), Norway (authorised, recruitment pending), Denmark (authorised, recruitment pending), Iceland (authorised, recruitment pending).
Therapeutic area(s): Diseases [C] - Immune System Diseases [C20]; Diseases [C] - Virus Diseases [C02]
Gender: Female, Male. Age: 18-64 years. Enrolment: 60.
Status: Authorised, recruitment pending. Decision date: 2026-07-13. Results received: No. Last updated: 2026-07-16.
Decision dates by country: DK: 2026-07-13, IS: 2026-07-14, SE: 2026-07-16, NO: 2026-07-14

Condition(s): HIV-1 disease
Product: NIVOLUMAB, Sodium Chloride 0.9% Intravenous Infusion BP, 3BNC117-LS, 10-1074-LS

Primary endpoint: Time from stopping ART to loss of immunological control of HIV-1 during ATI defined as either: 1) Six weeks of consecutive plasma HIV-1 RNA >1,000 copies/mL or confirmed >100,000 copies/mL 2) Confirmed (on two consecutive measurements) CD4+ T cell count <350 cells/mm3 3) Participant’s request or if the ATI in the opinion of the Sponsor or Investigator poses an unacceptable risk to the participant
Endpoint(s): Adverse events (AEs), serious AEs (SAEs), and biochemical lab abnormalities. Relationship to study drug and severity will be graded according to Division of AIDS (DAIDS) Table, v2.1, As defined in the primary endpoint: at week 24, 36, 48 and 60, Changes from baseline to weeks 8, 14, 24, 36 and 60 or ART-restart, whichever comes first as measured by flow cytometry, T cell elispot, and lymphocyte proliferation, Changes in the levels of intact proviral HIV-1 DNA per 106 CD4+ T cells from baseline to weeks 24 and 60 or ART-restart, whichever comes first as measured by PCR-based techniques, Changes in the distribution of immune cell subsets, activation and exhaustion markers from baseline to weeks 8, 14, 24 and 60 or ART-restart, whichever comes first as measured by flow cytometry, Changes in autologous neutralizing antibodies from baseline to weeks 24 and 60 or ART-restart, whichever comes first using neutralization assay

Source: https://euclinicaltrials.eu/ctis-public/view/2025-523725-17-00